EU clinical trial 2022-501508-82-00: A Phase 1, Open-Label, Dose-Escalation Study to Determine an Appropriate Starting Dose of Sacituzumab Govitecan in Subjects With Advanced or Metastatic Solid Tumor and Moderate Liver Impairment
Protocol code: IMMU-132-15
Sponsor: Gilead Sciences Inc. (Pharmaceutical company). Phase: Human Pharmacology (Phase I)- Other. Countries: France (ongoing, recruiting), Spain (authorised, recruiting), Italy (authorised, recruitment pending).
Therapeutic area(s): Diseases [C] - Neoplasms [C04]
Gender: Female, Male. Age: 18-64 years, 65+ years. Enrolment: 41.
Start date (EU): 2023-08-23. Decision date: 2023-02-01. Results received: No. Last updated: 2026-05-13.
Decision dates by country: FR: 2023-02-01, ES: 2025-12-18, IT: 2026-02-26

Condition(s): Solid Tumors

Source: https://euclinicaltrials.eu/ctis-public/view/2022-501508-82-00